EU clinical trial 2024-512475-12-01: Thrombosis prophylaxis and coagulation activation during neoadjuvant treatment in pancreatic cancer - Association to prognosis and recurrence.
Sponsor: HUS-Yhtymae, University Of Helsinki (Hospital/Clinic/Other health care facility, Educational Institution). Phase: Therapeutic use (Phase IV). Countries: Finland (ongoing, recruiting).
Therapeutic area(s): Diseases [C] - Neoplasms [C04]
Gender: Female, Male. Age: 18-64 years, 65+ years. Enrolment: 214.
Status: Ongoing, recruiting. Start date (EU): 2024-11-27. Decision date: 2024-11-27. Results received: No. Last updated: 2024-11-27.

Condition(s): We are investigating the efficacy and safety of enhanced thromboprophylaxis during neoadjuvant treatments for pancreatic cancer.
Product: innohep® 3500 anti-Xa IU injektioneste, liuos, kerta-annosruiskussa, Inhixa 6,000 IU (60 mg)/0.6 mL solution for injection in pre-filled syringe

Primary endpoint: As primary endpoints, we collect venous and arterial thrombotic events, bleeding complications, as well as information on disease progression and feasible time and cause of death. Patients are followed for at least five years or until death.
Endpoint(s): We will observe changes in the patient's coagulation activation from venous blood samples during neoadjuvant treatment and disease follow-up. Blood samples will be taken before the start of neoadjuvant treatments, between chemotherapy cycles, after neoadjuvant treatments, and (or after the start of palliative treatments if surgery is not feasible) at months 1, 3, 6, 12, 15, 24, and 36 along with other scheduled blood tests.

Source: https://euclinicaltrials.eu/ctis-public/view/2024-512475-12-01